EU clinical trial 2023-506464-14-00: A Phase 1/2, Open-label, Safety, Tolerability, Pharmacokinetics, and Antitumor Activity Study of Repotrectinib in Pediatric and Young Adult Subjects with Advanced or Metastatic Malignancies Harboring ALK, ROS1, or NTRK1-3 Alterations (CARE)
Protocol code: TPX-0005-07
Sponsor: Turning Point Therapeutics Inc. (Pharmaceutical company). Phase: Phase I and Phase II (Integrated)- Other. Countries: Denmark (ongoing, recruiting), Italy (authorised, recruiting), France (ongoing, recruiting), Spain (ongoing, recruiting).
Therapeutic area(s): Diseases [C] - Neoplasms [C04]
Gender: Female, Male. Age: 0-17 years, 18-64 years. Enrolment: 20.
Start date (EU): 2023-06-29. Decision date: 2024-02-07. Results received: No. Last updated: 2026-04-30.
Decision dates by country: IT: 2024-02-22, ES: 2024-02-07, DK: 2024-04-15, FR: 2024-02-09

Condition(s): Advanced solid tumors
Product: Repotrectinib (TPX-0005), Repotrectinib (TPX-0005), Repotrectinib (TPX-0005)

Primary endpoint: ORR as determined by BICR
Endpoint(s): DOR, TTR and CBR, Intracranial tumor response, Central nervous system (CNS) progression-free survival (CNS-PFS) in subjects with measurable brain metastases, PFS and OS, PK parameters, Type, incidence, severity, timing, seriousness, and relatedness of AEs and laboratory abnormalities

Source: https://euclinicaltrials.eu/ctis-public/view/2023-506464-14-00